EU clinical trial 2023-504397-38-00: A Multiple Dose Pharmacokinetic Study of AMX0035 in Participants with Impaired Hepatic Function and in Healthy Participants
Protocol code: A35-016
Sponsor: Amylyx Pharmaceuticals EMEA B.V., Amylyx Pharmaceuticals Inc. (Pharmaceutical company). Phase: Human Pharmacology (Phase I)- Other. Countries: Bulgaria (ended).
Therapeutic area(s): Not possible to specify
Gender: Female, Male. Age: 18-64 years, 65+ years. Enrolment: 32.
Status: Ended. Start date (EU): 2023-10-31. End date (EU): 2024-03-20. Decision date: 2023-08-23. Results received: No. Last updated: 2024-02-05.

Condition(s): Volunteers with Hepatic Impairment, Healthy volunteers

Source: https://euclinicaltrials.eu/ctis-public/view/2023-504397-38-00